EU clinical trial 2023-506611-17-00: A PHASE Ib/II, OPEN-LABEL, MULTICENTER, RANDOMIZED UMBRELLA STUDY EVALUATING THE EFFICACY AND SAFETY OF MULTIPLE IMMUNOTHERAPY-BASED TREATMENT COMBINATIONS IN PATIENTS WITH ADVANCED LIVER CANCERS (MORPHEUS LIVER)
Protocol code: GO42216
Sponsor: F. Hoffmann-La Roche AG (Pharmaceutical company). Phase: Phase I and Phase II (Integrated)- Other. Countries: France (ongoing, recruiting).
Therapeutic area(s): Diseases [C] - Neoplasms [C04]
Gender: Female, Male. Age: 18-64 years, 65+ years. Enrolment: 29.
Status: Ongoing, recruiting. Start date (EU): 2026-04-16. Decision date: 2024-05-13. Results received: No. Last updated: 2026-07-29.

Condition(s): Advanced liver cancers
Product: Tecentriq 1 200 mg concentrate for solution for infusion, RO7790118, RO7247669, Avastin 25 mg/ml concentrate for solution for infusion., ADG126, TPST-1120, RO7790118, Tiragolumab, RO7791094, RoActemra 20 mg/mL concentrate for solution for infusion, RO7790118

Primary endpoint: 1. ORR (determined by the investigator according to RECIST 1.1), 2. Incidence, nature, and severity of adverse events and laboratory abnormalities, 3. Change from baseline in vital signs and ECG parameters, 4. Change from baseline in targeted clinical laboratory test results
Endpoint(s): 1. PFS, 2. OS after randomization, 3. OS at specific timepoints, 4. DOR, 5. Disease control

Source: https://euclinicaltrials.eu/ctis-public/view/2023-506611-17-00